EU clinical trial 2025-521946-82-00: A DOSE-DETERMINATION STUDY OF SUGAMMADEX AS A ROCURONIUM DECURARIZATION AGENT IN CHILDREN UNDER 2 YEARS OF AGE
Sponsor: Centre Hospitalier Universitaire De Caen Normandie (Hospital/Clinic/Other health care facility). Phase: Therapeutic exploratory (Phase II). Countries: France (ongoing, recruiting).
Therapeutic area(s): Analytical, Diagnostic and Therapeutic Techniques and Equipment [E] - Anesthesia and Analgesia [E03]
Gender: Female, Male. Age: 0-17 years. Enrolment: 99.
Status: Ongoing, recruiting. Start date (EU): 2026-05-18. Decision date: 2025-11-12. Results received: No. Last updated: 2025-11-12.

Condition(s): Non-urgent non-cardiac surgical procedure or relative emergency >12h that will require curarisation with rocuronium and decurarisation with sugammadex
Product: Rocuronium Kabi, 10 mg/ml, roztwór do wstrzykiwań / do infuzji, Sugammadex Mylan 100 mg/mL solution for injection

Primary endpoint: Total dose of sugammadex, in mg/Kg, to obtain complete decurarisation: TOFc 4/4 and TOFr ≥ 90%. The total dose is obtained by adding the sub-doses of 0.2 mg/Kg administered cumulatively every 3+/- 1 minute to each child until a TOFr >90% is obtained.
Endpoint(s): Total dose of sugammadex administered below the recommendations for the adult population: yes / no., Total dose of sugammadex administered greater than the recommendations for the adult population: yes / no., Measurements of curarisation levels (TOFc and, where appropriate, TOFr) before the first injection and after each new injection of sugammadex., ˗ Occurrence of recurarisation phenomena during the decurarisation procedure: yes / no. At each decurarisation measurement, a recurarisation phenomenon was defined as: - A decrease of at least 2 units in TOFc, for subjects who had a TOFc < 4/4 at the previous time; - A gross decrease of at least 20% in TOFr or a return to a TOFc < 4/4, for subjects with a TOFc = 4/4 at the previous time., Intensity of initial block depth: TOFc < 2/4, TOFc ≥ 2/4., Total dose of rocuronium, in mg/Kg (induction + possible re-administrations)., Time (in minutes) between the last administration of rocuronium and the first administration of sugammadex., ˗ Occurrence of post-complete recurarisation, up to 60 minutes after the last administration of sugammadex: yes / no. A recurarisation is defined by the measurement of a TOFc < 4/4 or a TOFr < 90% after having observed a TOFr> 90%., Occurrence of adverse events related to the administration of sugammadex: recurarisation, respiratory events on awakening or in the ICU, drug hypersensitivity.

Source: https://euclinicaltrials.eu/ctis-public/view/2025-521946-82-00